EU clinical trial 2024-519041-29-02: The effect of additional pre-extubational loading dose of caffeine-citrate
Protocol code: NEOKOFF22
Sponsor: Semmelweis University (Educational Institution). Phase: Therapeutic use (Phase IV). Countries: Hungary (ongoing, recruiting).
Therapeutic area(s): Diseases [C] - Respiratory Tract Diseases [C08]
Gender: Female, Male. Age: 0-17 years. Enrolment: 226.
Status: Ongoing, recruiting. Start date (EU): 2025-01-15. Decision date: 2025-01-15. Results received: No. Last updated: 2026-05-06.

Condition(s): Extubation failure and bronchopulmonary dysplasia
Product: CAFFEINE CITRATE

Primary endpoint: Reintubation.
Endpoint(s): Frequency of apnoeas. Side effects (elevated heart rate, elevated blood pressure, gastric residuals) Necrotizing enterocolitis. Bronchopulmonary dysplasia. The progression or development of intraventricular hemorrhage or periventricular leukomalacia. Neurodevelopmental outcome.

Source: https://euclinicaltrials.eu/ctis-public/view/2024-519041-29-02